EU clinical trial 2024-511441-19-00: A 52-week, Phase 2, Open-label Trial to Evaluate the Long-term Safety and Tolerability of CVL-231 in Adult Participants With Schizophrenia
Protocol code: CVL-231-2003
Sponsor: Cerevel Therapeutics LLC (Pharmaceutical company). Phase: Therapeutic exploratory (Phase II). Countries: Hungary (ended), Bulgaria (ended).
Therapeutic area(s): Psychiatry and Psychology [F] - Mental Disorders [F03]
Gender: Female, Male. Age: 18-64 years, 65+ years. Enrolment: 300.
Status: Ended. Start date (EU): 2023-03-08. End date (EU): 2025-04-22. End date: 2025-06-25. Decision date: 2024-03-27. Results received: Yes. Last updated: 2025-05-22.
Decision dates by country: HU: 2024-03-27, BG: 2024-03-28

Condition(s): Schizophrenia
Product: EMRACLIDINE, EMRACLIDINE, EMRACLIDINE

Primary endpoint: "• Treatment-emergent adverse events • Clinically significant changes in vital sign measurements, body weight, physical and neurological examination results, ECG assessments, clinical laboratory assessments, and metabolic parameters • Clinically significant findings in suicidality assessed using the C-SSRS • Extrapyramidal symptoms evaluated using the change from Baseline in SAS, AIMS, and BARS assessments "

Source: https://euclinicaltrials.eu/ctis-public/view/2024-511441-19-00